EU clinical trial 2023-505783-11-00: An Open-Label, Phase I Clinical Trial to Assess the Effect of a Single Oral Dose of Acalabrutinib on Skin Prick Test Wheal Size in Adults, Aged 18 to 65 years, with Grass Pollen Allergy
Protocol code: AC-01
Sponsor: Alk-Abello A/S (Pharmaceutical company). Phase: Human Pharmacology (Phase I)- Other. Countries: Germany (ended).
Therapeutic area(s): Diseases [C] - Immune System Diseases [C20]
Gender: Female, Male. Age: 18-64 years, 65+ years. Enrolment: 12.
Status: Ended. Start date (EU): 2023-10-26. End date (EU): 2024-01-31. Decision date: 2023-10-19. Results received: Yes. Last updated: 2023-10-19.

Condition(s): grass pollen allergy
Product: ALK-prick Positiv-Kontrolle ist ein Histaminpräparat für die Pricktestung., Calquence, ALK-prick SQ - 225 Wiesenlieschgras - 10 HEP - Lösung für den Pricktest, ALK-prick Negativ-Kontrolle Pricktestlösung

Primary endpoint: SPT wheal size with 10 HEP Phleum pratense extract 15 and 5 minutes before intake of acalabrutinib and at 0, 5, 10, 15, 30 and 60 minutes after a single oral dose of acalabrutinib, Change in SPT wheal size with 10 HEP Phleum pratense extract between the SPT at each time point (at 5 minutes before intake of acalabrutinib and at 0, 5, 10, 15, 30 and 60 minutes after intake of acalabrutinib) and the SPT performed 15 minutes prior to intake of acalabrutinib
Endpoint(s): • Plasma concentrations of acalabrutinib at 0 (predose) and 5, 10, 15, 30 and 60 minutes after a single oral dose of acalabrutinib. • Time to maximum concentration in plasma (Tmax ) and maximum concentration in plasma (Cmax) of acalabrutinib • Change in SPT wheal size for the positive control between the SPT at each time point (at 5 minutes before intake of acalabrutinib and at 0, 5, 10, 15, 30 and 60 minutes after intake of acalabrutinib) and the SPT performed 15 minutes prior to intake of acalabrutinib, Safety and tolerability endpoints: • Treatment-emergent adverse events (TEAEs) • IMP-related TEAEs • Serious adverse events (SAEs) • TEAEs leading to discontinuation, time to discontinuation due to TEAEs • Vital signs, physical examination, electrocardiogram (ECG), and clinical laboratory values during treatment and at the EoT visit.

Source: https://euclinicaltrials.eu/ctis-public/view/2023-505783-11-00